EU clinical trial 2025-521845-26-00: A Phase 3, Randomized, Double-blind, Placebo-controlled, Study to Evaluate the Efficacy and Safety of Adjunctive KarXT for the Treatment of Mania, With or Without Mixed Features, in Individuals with Bipolar-I Disorder Taking Lithium, Valproate, or Lamotrigine
Protocol code: CN012-0046
Sponsor: Bristol-Myers Squibb Services Unlimited Company (Pharmaceutical company). Phase: Therapeutic confirmatory (Phase III). Countries: Romania (ongoing, recruiting), Poland (authorised, recruitment pending), France (authorised, recruitment pending), Italy (authorised, recruitment pending), Denmark (authorised, recruitment pending), Bulgaria (authorised, recruitment pending).
Therapeutic area(s): Psychiatry and Psychology [F] - Mental Disorders [F03]
Gender: Female, Male. Age: 18-64 years. Enrolment: 185.
Start date (EU): 2026-03-02. Decision date: 2026-01-15. Results received: No. Last updated: 2026-06-15.
Decision dates by country: DK: 2026-01-15, PL: 2026-01-19, IT: 2026-01-16, BG: 2026-02-16, FR: 2026-01-19, RO: 2026-01-19

Condition(s): BP-I mania or mania with mixed features
Product: KarXT, KarXT, KarXT Matching Placebo, KarXT, KarXT

Primary endpoint: Change from baseline in Young Mania Rating Scale (YMRS, used to evaluate manic symptoms) score at Week 5.
Endpoint(s): Change from baseline in CGI-BP (used to evaluate daily functioning) at Week 5.

Source: https://euclinicaltrials.eu/ctis-public/view/2025-521845-26-00